EU clinical trial 2024-515900-38-00: BOB1-TCR therapy for treatment of relapsed or refractory B-cell malignancies - A Phase 1/2 clinical trial
Protocol code: 1/BOB1
Sponsor: Leids Universitair Medisch Centrum (LUMC) (Hospital/Clinic/Other health care facility). Phase: Phase I and Phase II (Integrated)- First administration to humans. Countries: Netherlands (ongoing, recruiting).
Therapeutic area(s): Diseases [C] - Neoplasms [C04]
Gender: Female, Male. Age: 18-64 years, 65+ years. Enrolment: 22.
Status: Ongoing, recruiting. Start date (EU): 2026-06-05. Decision date: 2025-08-28. Results received: No. Last updated: 2026-02-09.

Condition(s): B-cell Acute Lymphoblastic Leukemia, Multiple Myeloma, Non-Hodgkin B-cell lymphoma
Product: LUMC-BOB1-B7-TCR.1, LUMC-BOB1-B7-TCR.1, LUMC-BOB1-B7-TCR.1

Primary endpoint: Phase 1: The proportion of manufacturing runs from which a LUMCBOB1-B7-TCR.1 drug product was generated at the intended dose., Phase 1: The proportion of included patients that received LUMC-BOB1- B7-TCR.1 treatment., Phase 1: The rate of dose-limiting toxicities (DLTs) within a specific dose cohort until 28 days after LUMC-BOB1-B7-TCR.1 infusion., Phase 1: The maximum tolerated dose evaluated by Bayesian Dose Interval (BOIN) design with a target toxicity rate of 0.3, which is defined as the rate of DLTs within a dose cohort until 28 days after LUMC-BOB1-B7- TCR.1 infusion., Phase 1: The recommended dose for patient treatment in phase 2., Phase 2: Safety and toxicity assessment of LUMC-BOB1-B7-TCR.1 treatment per (serious) adverse event (AE) up to 2 years after infusion, reported according to ASTCT and CTCAE., Phase 2: Response rate 12 weeks after infusion, response is defined as absence of circulating B cells and/or best objective response as defined in literature.

Source: https://euclinicaltrials.eu/ctis-public/view/2024-515900-38-00